EU clinical trial 2025-523965-97-00: The Expression of Fibroblast Activation Protein in Patients with Non-Small Cell Lung Cancer Patients
Sponsor: Turku University Hospital (Hospital/Clinic/Other health care facility). Phase: Therapeutic exploratory (Phase II). Countries: Finland (authorised, recruitment pending).
Therapeutic area(s): Diseases [C] - Neoplasms [C04]
Gender: Female, Male. Age: 18-64 years. Enrolment: 60.
Status: Authorised, recruitment pending. Decision date: 2025-12-16. Results received: No. Last updated: 2025-12-16.

Condition(s): Non small cell lung cancer
Product: [18F]FAPI-74

Primary endpoint: SUVmax, SUVmean and SUVpeak of the primary tumor, tumor recurrence, lymph node metastasis or distant metastasis
Endpoint(s): Histological confirmation of cancer in lesions with FAPI PET -imaging

Source: https://euclinicaltrials.eu/ctis-public/view/2025-523965-97-00